EU clinical trial 2023-508812-45-00: A Phase 2/3, Multicenter, Randomized, Double-blind, Placebo-controlled Study to Evaluate the Efficacy, Safety, and Tolerability of BHV-7000 as Adjunctive Therapy in Subjects with Idiopathic Generalized Epilepsy with Generalized Tonic-clonic Seizures, with Open-label Extension
Protocol code: BHV7000-304
Sponsor: Biohaven Therapeutics Ltd. (Pharmaceutical company). Phase: Phase II and Phase III (Integrated). Countries: Belgium (ended), Netherlands (ended), Germany (ended), Austria (ended), Italy (ended), Finland (ended), Poland (ended), France (ended), Portugal (ended), Spain (ended), Croatia (ended).
Therapeutic area(s): Diseases [C] - Nervous System Diseases [C10]
Gender: Female, Male. Age: 18-64 years, 65+ years. Enrolment: 122.
Status: Ended. Start date (EU): 2024-11-11. End date (EU): 2026-03-12. End date: 2026-03-13. Decision date: 2024-10-07. Results received: No. Last updated: 2025-09-12.
Decision dates by country: NL: 2024-10-14, HR: 2024-10-14, AT: 2024-10-14, PL: 2024-10-13, ES: 2024-10-08, IT: 2024-10-11, FR: 2024-10-11, BE: 2024-10-11, FI: 2024-10-08, DE: 2024-10-09, PT: 2024-10-07

Condition(s): Idiopathic Generalized Epilepsy with Generalized Tonic-clonic Seizures
Product: BHV-7000, Placebo for BHV-7000, BHV-7000

Primary endpoint: Time to the second day with a GTC seizure during the double-blind phase.
Endpoint(s): - Proportion of subjects with GTC seizure freedom during the 24-week DBP, estimated using Kaplan-Meier methods. - Safety is assessed by the number of unique subjects with deaths, SAEs, AEs leading to discontinuation, moderate and severe AEs, and grade 3 and grade 4 laboratory abnormalities.

Source: https://euclinicaltrials.eu/ctis-public/view/2023-508812-45-00